EU clinical trial 2024-516478-31-00: A Phase 3, Randomized, Double-Blind, Placebo-Controlled Study of Cabozantinib (XL184) in Subjects with Radioiodine-Refractory Differentiated Thyroid Cancer Who Have Progressed after Prior VEGFR-Targeted Therapy
Protocol code: XL184–311
Sponsor: Exelixis Inc. (Pharmaceutical company). Phase: Therapeutic confirmatory (Phase III). Countries: Romania (ongoing, recruitment ended), Poland (ongoing, recruitment ended), Spain (ended).
Therapeutic area(s): Diseases [C] - Neoplasms [C04]
Gender: Female, Male. Age: 0-17 years, 18-64 years, 65+ years. Enrolment: 6.
Start date (EU): 2019-06-12. Decision date: 2024-10-23. Results received: No. Last updated: 2025-09-16.
Decision dates by country: RO: 2024-10-28, ES: 2024-10-23, PL: 2024-10-28

Condition(s): progressed thyroid cancer
Product: CABOMETYX 60 mg film-coated tablets, Cabozantinib-matched placebo identical to the IMP apart from the active substance, CABOMETYX 20 mg film-coated tablets

Primary endpoint: Progression-free survival (PFS) per Response Evaluation Criteria in Solid Tumors (RECIST) 1.1 by blinded independent radiology committee (BIRC), Objective response rate (ORR) per RECIST 1.1 by BIRC
Endpoint(s): Overall survival (OS), Duration of objective tumor response, Safety and tolerability, Pharmacokinetics (PK) of cabozantinib, Relationship of baseline and postbaseline changes in biomarkers, serum thyroglobulin (Tg), and circulating tumor cells (CTCs) and/or circulating DNA (ctDNA) with treatment and/or clinical outcome assessments may be performed, Change in mobility, self-care, usual activities, pain/discomfort, anxiety/depression, and global health as assessed by the EuroQol Health questionnaire instrument (EQ-5D-5L), Health care resource utilization

Source: https://euclinicaltrials.eu/ctis-public/view/2024-516478-31-00